EU clinical trial 2023-506330-73-00: A Master rollover study to provide continued access to, and assess, long term safety of the study drugs.
Protocol code: ROMast-001
Sponsor: Daiichi Sankyo Inc. (Pharmaceutical company). Phase: Therapeutic confirmatory (Phase III). Countries: France (ongoing, recruiting), Spain (ongoing, recruiting), Belgium (ongoing, recruiting), Italy (ongoing, recruiting).
Therapeutic area(s): Diseases [C] - Neoplasms [C04]
Gender: Female, Male. Age: 18-64 years, 65+ years. Enrolment: 64.
Status: Ongoing, recruiting. Start date (EU): 2024-03-13. Decision date: 2024-02-23. Results received: No. Last updated: 2026-01-16.
Decision dates by country: BE: 2024-03-04, FR: 2024-02-23, IT: 2024-03-11, ES: 2024-02-27

Condition(s): Advanced (unresectable or metastatic) human epidermal growth receptor 2 (HER2)-expressing/HER2-mutated solid tumors
Product: DS-8201a

Primary endpoint: TEAEs leading to study drug discontinuation and/or dose reduction, treatment-emergent serious adverse events (TESAEs), and treatment-emergent adverse events of special interest (AESIs).

Source: https://euclinicaltrials.eu/ctis-public/view/2023-506330-73-00